EU clinical trial 2024-518892-72-00: Phase 2, open-label, multicentre, single-arm study to evaluate the activity of the combination of EGFR inhibitors and c-MET inhibitors in patients with platinum-resistant head and neck squamous cell carcinoma after relapse to immunotherapy.
Protocol code: TEPMEETCET
Sponsor: Azienda Socio Sanitaria Territoriale Degli Spedali Civili Di Brescia (Hospital/Clinic/Other health care facility). Phase: Therapeutic exploratory (Phase II). Countries: Italy (authorised, recruitment pending).
Therapeutic area(s): Diseases [C] - Neoplasms [C04]
Gender: Female, Male. Age: 18-64 years, 65+ years. Enrolment: 30.
Status: Authorised, recruitment pending. Decision date: 2025-01-31. Results received: No. Last updated: 2026-06-12.

Condition(s): Head and neck cancer
Product: CETUXIMAB, TEPOTINIB

Primary endpoint: Objective response (OR, confirmed complete response [CR] or partial response [PR]) determined according to RECIST Version 1.1 assessed by the Investigators

Source: https://euclinicaltrials.eu/ctis-public/view/2024-518892-72-00